EU clinical trial 2022-500850-40-01: The Colchicine and atrial fibrillation trial
Sponsor: Gentofte Hospital (Hospital/Clinic/Other health care facility). Phase: Therapeutic confirmatory (Phase III). Countries: Denmark (ongoing, recruiting).
Therapeutic area(s): Diseases [C] - Cardiovascular Diseases [C14]
Gender: Female, Male. Age: 18-64 years, 65+ years. Enrolment: 500.
Status: Ongoing, recruiting. Start date (EU): 2023-05-26. Decision date: 2022-09-12. Results received: No. Last updated: 2024-10-14.

Condition(s): Atrial fibrillation or atrial flutter
Product: Placebo will be identical in appearance and contain, the following ingredients: lactosemonohydrate, potato starch, spiritus gelatinae 5%, magnesium stearate, talcum., COLCHICINE

Primary endpoint: Time to first AF admission from start of medication measured in days
Endpoint(s): Accumulated number of readmissions for symptomatic AF at 12 months, Change in echocardiographic measurements at 12 months, Change of life quality score at 12 months, Change in potentiel side effects at 12 months

Source: https://euclinicaltrials.eu/ctis-public/view/2022-500850-40-01